EU clinical trial 2024-513100-34-00: A study to test different doses of obrixtamig (BI 764532) in patients with small cell lung cancer and other neuroendocrine tumours that are positive for DLL3.
Protocol code: 1438-0001
Sponsor: Boehringer Ingelheim International GmbH (Industry). Phase: Human Pharmacology (Phase I)- First administration to humans. Countries: Germany (ongoing, recruiting), Spain (ongoing, recruiting).
Therapeutic area(s): Diseases [C] - Neoplasms [C04]
Gender: Female, Male. Age: 18-64 years, 65+ years. Enrolment: 235.
Status: Ongoing, recruiting. Start date (EU): 2020-07-15. Decision date: 2024-09-04. Results received: No. Last updated: 2026-05-10.
Decision dates by country: DE: 2024-09-04, ES: 2024-09-09

Condition(s): Small Cell Lung Carcinoma and other neuroendocrine neoplasms expressing DLL3

Source: https://euclinicaltrials.eu/ctis-public/view/2024-513100-34-00